EU clinical trial 2023-508357-58-00: An open-label, first-in-human, dose-escalation/expansion study of SAR443579 administered as single agent by intravenous infusion in adult and pediatric participants with relapsed or refractory acute myeloid leukemia (R/R AML), B-cell acute lymphoblastic leukemia (B-ALL), high risk-myelodysplasia (HR-MDS), or blastic plasmacytoid dendritic cell neoplasm (BPDCN)
Protocol code: TCD17197
Sponsor: Sanofi-Aventis Recherche & Developpement (Pharmaceutical company). Phase: Phase I and Phase II (Integrated)- First administration to humans. Countries: France (ended), Netherlands (ended).
Therapeutic area(s): Diseases [C] - Neoplasms [C04]
Gender: Female, Male. Age: 0-17 years, 18-64 years, 65+ years. Enrolment: 57.
Status: Ended. Start date (EU): 2022-07-04. End date (EU): 2025-03-12. End date: 2025-06-13. Decision date: 2024-03-11. Results received: Yes. Last updated: 2025-06-23.
Decision dates by country: FR: 2024-03-11, NL: 2024-03-13

Condition(s): Acute lymphocytic leukaemia- Acute myeloid leukaemia refractory - Myelodysplastic syndrome - Blastic plasmacytoid dendritic cell neoplasia
Product: PROMETHAZINE, DIPHENHYDRAMINE, CETIRIZINE, DEXCHLORPHENIRAMINE, PARACETAMOL, SAR443579

Primary endpoint: Escalation Part: Incidence of dose-limiting toxicity (DLT), Japan Cohort C: Incidence of DLT in Japanese participant, Expansion/Optimization part (Cohorts A1, A2 & D), AML: Proportion of participants who have a CR + CRh + CRi according to the modified AML IWG 2003 criteri, Expansion/Optimization part (Cohort B), MDS: Overall response rate (CR + CR equivalent + PR + CRL + CRh + HI) according to the IWG 2023 MDS response criteria
Endpoint(s): Expansion/Optimization part – Cohorts A, B and D: Recommended dose for expansion (RDE), Escalation and Expansion/Optimization parts – Cohorts A, B, C and D: Number of participants with TEAEs, Escalation and Expansion/Optimization parts – Cohorts A, B, C and D: Ctrough, Escalation and Expansion/Optimization parts – Cohorts A, B, C and D: Incidence of ADA, Escalation and Expansion/Optimization parts – Japan Cohort C, AML: Rate of CR + CRh + CRi per AML 2003 modified IWG response criteria, Escalation and expansion/Optimization parts – Japan Cohort C, MDS: CR rate and ORR rate per IWG 2023 MDS response criteria for escalation part and ORR rate per IWG 2023, Escalation and Expansion/Optimization parts – Japan Cohort C, B-ALL: Rate of CR + CRh + CRi as defined by National Comprehensive Cancer Network (NCCN), Expansion/Optimization part – Cohorts A and D: Overall response rate (ORR), Expansion/Optimization part – Cohorts A and D: Duration of CR + CRh + CRi (Duration of CRc), Expansion/Optimization part – Cohorts A and D: Duration of CR + CRi + CRh + PR + MLFS (Duration of overall response rate), Expansion/Optimization part – Cohorts A and D: Alternative CR rate, Expansion/Optimization part – Cohorts A and D: Duration of CR + CRh (Duration of alternative CR), Expansion/Optimization part – Cohorts A and D: Event-free survival (EFS), Expansion/Optimization part – Cohorts A and D: Overall survival (OS), Expansion/Optimization part – Cohorts A and D: Rate of hematopoietic stem cell transplantation (HSCT), Expansion/Optimization part – Cohorts A and D: Time to treatment failure (TTF), Expansion/Optimization part – Cohorts A and D: Rate of conversion from transfusion dependence, Expansion/Optimization part – Cohorts A and D: Rate of participants who are transfusion independent at baseline and remain independent during 56-day postbaseline period, Expansion/Optimization part – Cohort B: Alternative CR rate, Expansion/Optimization part – Cohort B: Duration of ORR, Expansion/Optimization part – Cohort B: Eventfree survival (EFS), Expansion/Optimization part – Cohort B: Overall survival (OS), Expansion/Optimization part – Cohort B: Rate of hematopoietic stem cell transplantation (HSCT), Expansion/Optimization part – Cohort B: Time to treatment failure (TTF), Expansion/Optimization part – Cohort B: Duration of alternative CR (CR + CR equivalent + CRL + CRh), Expansion/Optimization part – Cohort B: Progression free survival (PFS)

Source: https://euclinicaltrials.eu/ctis-public/view/2023-508357-58-00